EU clinical trial 2023-507590-18-00: A Long-term Multicenter Open-label Study to Evaluate the Long-term Safety and Durability of Effect of XTMAB-16 in Patients With Pulmonary Sarcoidosis With or Without Extra pulmonary Involvement
Protocol code: XTMAB-16-202
Sponsor: Xentria Inc. (Pharmaceutical company). Phase: Therapeutic exploratory (Phase II). Countries: Czechia (ongoing, recruiting), Denmark (authorised, recruitment pending), Poland (ongoing, recruiting), Spain (authorised, recruitment pending), Italy (authorised, recruitment pending).
Therapeutic area(s): Diseases [C] - Respiratory Tract Diseases [C08]
Gender: Female, Male. Age: 18-64 years, 65+ years. Enrolment: 24.
Start date (EU): 2025-06-03. Decision date: 2025-01-15. Results received: No. Last updated: 2026-02-05.
Decision dates by country: CZ: 2025-01-16, IT: 2025-01-20, ES: 2025-01-15, DK: 2025-01-18, PL: 2025-01-21

Condition(s): Pulmonary sarcoidosis with or without extrapulmonary manifestations
Product: XTMAB-16

Primary endpoint: 1. Rate of Adverse Events (AEs), including Serious Adverse Events (SAEs), and Adverse Events of Special Interests (AESIs) throughout the study duration
Endpoint(s): 1. Total corticosteroid dose: evaluation of accumulated dose over the first 12 weeks of the study o Average daily dose o Percentage of time in study with dose ≤ 5 mg, 2. Proportion of participants with treatment failure and time to treatment failure, as defined in Section 5.4, 3. Change in quality-of-life measures from baseline to assessment timepoints throughout the study duration: o King’s Sarcoidosis Questionnaire (KSQ) – Lung Module o KSQ – General Health Status Module o Leicester Cough Questionnaire (LCQ) o Steroid toxicity questionnaire (STQ), 4. Change in pulmonary function tests from baseline to assessment timepoints throughout the study duration: o Forced vital capacity (FVC), 5. Number and percentage of participants who test positive for XTMAB-16 anti-drug antibody (ADA), Number and percentage of participants who test positive for XTMAB-16 neutralizing antibodies (nAb), 7. Absolute and percent change in biomarkers from baseline to assessment timepoints throughout the study duration: • Angiotensin converting enzyme (ACE) • Interleukin-6 (IL-6) • Soluble interleukin-2 receptor (sIL-2R) • Soluble tumor necrosis factor alpha (sTNFα) •C-reactive protein (CRP) • Interleukin-1b (IL-1b) •Calcitriol (Vitamin D1, 25)

Source: https://euclinicaltrials.eu/ctis-public/view/2023-507590-18-00